EU clinical trial 2022-502084-38-00: (20321) An open-label, single arm, roll-over study to provide continued treatment with darolutamide in participants who were enrolled in previous Bayer sponsored studies
Protocol code: BAY1841788/20321
Sponsor: Bayer Consumer Care AG (Pharmaceutical company). Phase: Therapeutic confirmatory (Phase III). Countries: Belgium (ended), Germany (ended), Finland (ended), Lithuania (ongoing, recruitment ended), Spain (ended), Bulgaria (ended), Poland (ended), Netherlands (ended), Estonia (ended), Slovakia (ended), Romania (ended), Sweden (ended), Latvia (ended), Czechia (ended), Hungary (ongoing, recruitment ended), France (ended), Italy (ended).
Therapeutic area(s): Diseases [C] - Neoplasms [C04]
Gender: Male. Age: 18-64 years, 65+ years. Enrolment: 250.
Start date (EU): 2020-10-16. Decision date: 2023-05-23. Results received: No. Last updated: 2026-02-17.
Decision dates by country: SK: 2023-05-24, SE: 2023-05-29, FI: 2023-05-24, BG: 2023-05-29, DE: 2023-05-24, BE: 2023-05-26, EE: 2023-05-24, IT: 2023-05-26, NL: 2023-05-23, FR: 2023-05-26, ES: 2023-05-29, CZ: 2023-05-24, HU: 2023-05-25, LV: 2023-05-23, LT: 2023-05-26, PL: 2023-05-29, RO: 2023-05-26

Condition(s): Cancer
Product: BAY 1841788

Primary endpoint: Incidence of TEAEs (Treatment-emergent adverse events), Incidence of TESAEs (Treatment-emergent serious adverse events), Incidence of drug-related TEAEs and TESAEs
Endpoint(s): Frequency of dose modifications

Source: https://euclinicaltrials.eu/ctis-public/view/2022-502084-38-00